EU clinical trial 2024-513662-18-00: A phase 1/2, open-label, safety, tolerability and preliminary efficacy study of implantation into one eye of hESC-derived RPE (Human Embryonic Stem Cell Derived Retinal Pigment Epithelium (RPE)) in patients with retinitis pigmentosa due to monogenic mutation
Protocol code: STREAM
Sponsor: Centre D'Etude Des Cellules Souches (Pharmaceutical company). Phase: Phase I and Phase II (Integrated)- First administration to humans. Countries: France (ongoing, recruiting).
Therapeutic area(s): Diseases [C] - Eye Diseases [C11]
Gender: Female, Male. Age: 18-64 years. Enrolment: 12.
Status: Ongoing, recruiting. Start date (EU): 2019-08-19. Decision date: 2024-06-12. Results received: No. Last updated: 2025-04-02.

Condition(s): Patients with retinitis pigmentosa due to monogenic mutation
Product: MYCOPHENOLIC ACID, ISTEM-01

Primary endpoint: Safety and tolerability measured by the incidence of adverse events (AE) or serious adverse events (SAE) evaluated by changes in ophthalmologic exams, laboratory parameters, vital signs and in the physical examination from baseline to each visit, will be evaluated for each patient over 56 weeks.
Endpoint(s): Placement and position of the therapeutic patch by serial spectral domain Ocular Coherence Tomography (OCT) scan at Baseline, and by study visit, Change in leakage or perfusion in normal fundal vasculature and presence of abnormal vasculature by fundus fluorescein angiography at Baseline, weeks 24 and 56 and yearly during the long-term follow-up study., Change in thickness of RPE layer by B-mode orbital ultrasound at Baseline, weeks 24, and 56 and yearly during the long-term follow-up study., Change in eye exam and IntraOcular Pressure (IOP) from baseline, and by study visit, Change in ETDRS/ best corrected visual acuity (BCVA) from baseline and by study visit, Change in kinetic perimetry from baseline, at weeks 4, 8, 12, 24, 36, 48 and 56 and yearly during the long-term follow-up study., Evidence of retinal and RPE functionnality by global, pattern and multifocal ERG at baseline and week 56 and yearly during the long term follow-up period, Functional survival of retinal photoreceptors by microperimetry over hESC-derived RPE at weeks 4, 8, 12, 24, 36, 48 and 56 and yearly during the long term follow-up period

Source: https://euclinicaltrials.eu/ctis-public/view/2024-513662-18-00